EU clinical trial 2024-514215-98-00: Phleum pratense and Dactylis glomerata allergen extracts. Determination of the in vivo histamine equivalent prick test units.
Protocol code: G110-STD-071
Sponsor: Inmunotek S.L. (Pharmaceutical company). Phase: Therapeutic exploratory (Phase II). Countries: Spain (ended).
Therapeutic area(s): Diseases [C] - Immune System Diseases [C20]
Gender: Female, Male. Age: 18-64 years. Enrolment: 30.
Status: Ended. Start date (EU): 2024-11-26. End date (EU): 2025-02-07. Decision date: 2024-11-06. Results received: Yes. Last updated: 2024-11-06.

Condition(s): Allergy to Phleum pratense and Dactylis glomerata.
Product: Prick test of enriched Phleum pratense pollen extract, Prick test of enriched Dactylis glomerata pollen extract, Skin Prick Test Positive control, Skin Prick Test Negative control

Primary endpoint: The primary efficacy endpoint involves measuring the area (mm2) of the induced wheal on the skin upon applying each of the 3 concentrations of each allergenic extract (Phleum pratense and Dactylis glomerata), as well as those induced by positive (histamine) and negative controls, through the prick test.
Endpoint(s): Overall rate, seriousness, and ratio of any adverse event (AE) by administration and by subject., Assessment of administration site reactions, systemic reactions and any medication administered for the treatment of adverse reaction (AR).

Source: https://euclinicaltrials.eu/ctis-public/view/2024-514215-98-00